EU clinical trial 2023-507002-14-00: CLL-Frail - A prospective, multicenter phase II trial of acalabrutinib in very old (≥80y) or frail CLL-Patients
Protocol code: CLL-Frail
Sponsor: University Of Cologne (Educational Institution). Phase: Therapeutic exploratory (Phase II). Countries: Austria (ended), Germany (ended).
Therapeutic area(s): Diseases [C] - Neoplasms [C04]
Gender: Female, Male. Age: 18-64 years, 65+ years. Enrolment: 53.
Status: Ended. Start date (EU): 2021-05-20. End date (EU): 2025-05-08. Decision date: 2024-04-24. Results received: Yes. Last updated: 2025-03-10.
Decision dates by country: AT: 2024-04-26, DE: 2024-04-24

Condition(s): treatment-naïve or relapsed/refractory chronic lymphocytic leukemia
Product: Calquence 100 mg film-coated tablets, Calquence 100 mg hard capsules

Primary endpoint: Overall response rate (ORR) at initial response assessment (cycle 7, day 1 = approx. 6 months after initiation of therapy).
Endpoint(s): ORR at final restaging (cycle 25, day 1 = approx. 24 months after initiation of therapy)., Overall survival (OS)., Progression free survival (PFS)., Event-free survival (EFS)., Duration of response., Time to next CLL treatment (TTNT)., Feasibility parameters: o Modification of treatment and reasons. o Treatment discontinuation: early discontinuation of treatment and reasons. o Treatment exposure: total cumulative dose, dose intensity, time on treatment (any dose), time on treatment (full dose), days with 0 dose., Safety parameters: Type, frequency, and severity of o adverse events (AEs) and o adverse events of special interest (AESI) and adverse events of particular interest (AEPI) including falls and delirium as typical adverse geriatric outcomes and their relationship to study treatment.

Source: https://euclinicaltrials.eu/ctis-public/view/2023-507002-14-00